EU clinical trial 2023-504388-18-00: (21824) A phase 3, single group treatment, open-label study to evaluate the safety of BAY 94-9027 infusions for prophylaxis and treatment of bleeding in previously treated children aged 7 to <12 years with severe hemophilia A
Protocol code: BAY 94-9027/21824
Sponsor: Bayer Consumer Care AG, Bayer AG (Pharmaceutical company). Phase: Therapeutic confirmatory (Phase III). Countries: Norway (ended), Italy (ended).
Therapeutic area(s): Diseases [C] - Hemic and Lymphatic Diseases [C15]
Gender: Male. Age: 0-17 years. Enrolment: 4.
Status: Ended. Start date (EU): 2022-09-26. End date (EU): 2025-03-10. End date: 2025-06-25. Decision date: 2024-03-12. Results received: Yes. Last updated: 2024-10-25.
Decision dates by country: IT: 2024-03-18, NO: 2024-03-12

Condition(s): Severe hemophilia A (<1% FVIII:C)
Product: Jivi 500 IU powder and solvent for solution for injection, Jivi 1000 IU powder and solvent for solution for injection

Primary endpoint: AESI (hypersensitivity and LOE) associated with the first 4 EDs leading to discontinuation
Endpoint(s): Adverse drug reactions (ADRs), Anti-drug antibody (ADA) development, Inhibitor development, Annualized bleeding rate (ABR), BAY94-9027 consumption, Number of infusions/month and year (Annualized Infusion Rate)

Source: https://euclinicaltrials.eu/ctis-public/view/2023-504388-18-00